EU clinical trial 2024-510716-71-00: Ocrelizumab VErsus Rituximab off-Label at the Onset of Relapsing MS Disease (OVERLORD-MS)
Sponsor: Helse Bergen HF (Hospital/Clinic/Other health care facility). Phase: Therapeutic confirmatory (Phase III). Countries: Norway (ongoing, recruiting), Sweden (ongoing, recruitment ended).
Therapeutic area(s): Diseases [C] - Nervous System Diseases [C10]
Gender: Female, Male. Age: 18-64 years. Enrolment: 214.
Start date (EU): 2020-10-21. Decision date: 2024-10-09. Results received: No. Last updated: 2026-04-08.
Decision dates by country: NO: 2024-10-09, SE: 2024-10-10

Condition(s): Multiple Sclerosis
Product: Ocrevus 300 mg concentrate for solution for infusion, MabThera 500 mg concentrate for solution for infusion

Primary endpoint: Proportion of patients with no new or enlarging T2-weighted brain MRI lesions from month 6 (re-baseline) to month 24, SWITCH: Proportion of patients with no new or enlarging T2-weighted brain MRI lesions from month 24 to month 36, REDUCE: Proportion of patients with no new or enlarging T2-weighted brain MRI lesions from month 36 to month 60 compared to the period before (month 0-36
Endpoint(s): The annual relapse rate from baseline to month 24, Proportion of patients without relapses from baseline to month 24, Proportion of patients with progression in SDMT from baseline to month 24. Progression in SDMT is defined as patients experiencing a reduction of 15% or more from baseline (Strober, DeLuca et al. 2019, Marstrand, Osterberg et al. 2020), Frequency of SAE/SAR and AESI during 24 months of treatment, The frequency of immediate and delayed infusion reactions during 24 months of treatment, The frequency of infections during 24 months of treatment, The frequency any malignancies during 24 months of treatment, Proportion of patients with no new or enlarging T2-weighted brain MRI lesions from baseline to month 6, and from baseline to month 24, Proportion of patients without new gadolinium enhancing T1-weighted brain MRI lesions at month 6, month 12 and month 24, Change in brain volumes from baseline to month 24 and from month 6 to month 24, SWITCH: The annual relapse rate from month 30 to month 36, SWITCH: Proportion of patients without relapses from month 30 to month 36, SWITCH: Proportion of patients without new gadolinium enhancing T1-weighted brain MRI lesions from month 24 to month 36, SWITCH: Change in brain volumes from month 24 to month 36, SWITCH: Proportion of patients with 6-months confirmed disability progression (6M-CDP) as measured by the Expanded disability status scale (EDSS) from month 30 to month 36, SWITCH: Proportion of patients with 6-months confirmed disability improvement (6M-CDI) as measured by the Expanded disability status scale (EDSS) from month 30 to month 36, SWITCH: Proportion of patients with 6M-CDP in SDMT from month 30 to month 36, SWITCH: Frequency of SAE/SAR and AESI from month 30 to month 36, SWITCH: The frequency of immediate and delayed infusion reactions from month 30 to month 36, SWITCH: The frequency of infections from month 30 to month 36, SWITCH: The frequency any malignancies from month 30 to month 36, REDUCE: The annual relapse rate from month 36 to month 60, REDUCE: Proportion of patients without relapses from month 36 to month 60, REDUCE: Proportion of patients with no new or enlarging T2-weighted brain MRI lesions from month 36 to month 60, REDUCE: Change in brain volumes from month 36 to month 60, REDUCE: Proportion of patients with 6-months confirmed disability progression (6M-CDP) as measured by the Expanded disability status scale (EDSS) (Kurtzke 1983) from month 36 to month 60, REDUCE: Proportion of patients with 6-months confirmed disability improvement (6M-CDI) as measured by the Expanded disability status scale (EDSS) (Kurtzke 1983) from month 36 to month 60, REDUCE: Proportion of patients with 6M-CDP in SDMT from month 36 to month 60, REDUCE: Frequency of SAE/SAR and AESI from month 36 to month 60, REDUCE: The frequency of grade 2 or above immediate and delayed infusion reactions from month 36 to month 60, REDUCE: The frequency of grade 2 or above infections from month 36 to month 60, REDUCE: The frequency any malignancies from month 36 to month 60, Proportion of patients with 6-months confirmed disability progression (6M-CDP) as measured by the Expanded disability status scale (EDSS) (Kurtzke 1983) from baseline to month 24.EDSS at month 24 is confirmed at month 30 (6M-CDP is defined in section 8.2.3)., Proportion of patients with 6-months confirmed disability improvement (6M-CDI) as measured by the Expanded disability status scale (EDSS) (Kurtzke 1983) from baseline to month 24. EDSS at month 24 is confirmed at month 30 (6M-CDI is defined in section 8.2.3), SWITCH: Proportion of patients with no new or enlarging T2-weighted brain MRI lesions from month 24 to month 36

Source: https://euclinicaltrials.eu/ctis-public/view/2024-510716-71-00